EU clinical trial 2024-514577-22-00: In vivo PET of synaptic density in cognitive disorders: prospective evaluation of neuronal dysfunction and relation to symptomatology.
Sponsor: UZ Leuven (Hospital/Clinic/Other health care facility). Phase: Human Pharmacology (Phase I)- Other. Countries: Belgium (ended).
Therapeutic area(s): Analytical, Diagnostic and Therapeutic Techniques and Equipment [E] - Diagnosis [E01]
Gender: Female, Male. Age: 18-64 years, 65+ years. Enrolment: 150.
Status: Ended. Start date (EU): 2024-07-12. End date (EU): 2025-07-08. Decision date: 2024-06-19. Results received: No. Last updated: 2024-06-19.

Condition(s): Cognitive Disorders including Alzheimer's Disease, Frontotemporal dementia, Lewy Body Disease and psychiatric disorders.

Source: https://euclinicaltrials.eu/ctis-public/view/2024-514577-22-00